EU clinical trial 2023-509256-34-00: A Phase 1/2 Dose-Exploration and Dose-Expansion Study to Evaluate the Safety and Efficacy of BEAM-302 in Adult Patients with Alpha-1 Antitrypsin Deficiency (AATD)-Associated Lung Disease and/or Liver Disease
Protocol code: BTX-302-001
Sponsor: Beam Therapeutics Inc. (Laboratory/Research/Testing facility). Phase: Phase I and Phase II (Integrated)- First administration to humans. Countries: Netherlands (ongoing, recruiting), Ireland (authorised, recruiting).
Therapeutic area(s): Not possible to specify
Gender: Female, Male. Age: 18-64 years. Enrolment: 34.
Start date (EU): 2025-02-06. Decision date: 2024-12-02. Results received: No. Last updated: 2026-07-28.
Decision dates by country: IE: 2025-02-21, NL: 2024-12-02

Condition(s): Alpha-1 Antitrypsin Deficiency (AATD)-Associated Lung Disease and/or Liver Disease
Product: BEAM-302

Primary endpoint: Phase 1 (Dose Exploration) Primary Endpoint: Rates of treatment-emergent adverse events (TEAEs) and serious adverse events (SAEs), Phase 2 (Dose Expansion) Primary Endpoint: Absolute blood levels of total AAT, Z-AAT, and M-AAT, Phase 2 (Pivotal Cohort) Primary Endpoint: Mean total AAT in blood through month 12, Phase 2 (Pivotal Cohort) Primary Endpoint: Mean functional AAT in blood through Month 12
Endpoint(s): Secondary endpoints apply to the entire study unless preceded with “Phase 1 (Dose Exploration)” or “Phase 2 (Dose Expansion).”, • Phase 1 (Dose Exploration): Absolute blood levels of total AAT, • Phase 2 (Dose Expansion): Rates of TEAEs and SAEs, Phase 1 (Dose Exploration): Change from baseline in blood levels of total AAT, Phase 1 (Dose Exploration): Blood levels of Z-AAT and M-AAT, Phase 1 (Dose Exploration): Change from baseline in blood levels of functional AAT, Phase 1 (Dose Exploration): Area under the plasma concentration-time curve (AUC) from time zero to the time of the last measurable concentration (AUC0-last), AUC from time zero to infinity (AUC∞), maximum concentration (Cmax), time to maximum concentration (Tmax), terminal half-life (t½) for the plasma levels of mRNA, gRNA, and lipids (ALC-0366 and ALC-0159), Phase 1 (Dose Exploration): Change in COPD exacerbations (defined in Appendix 2), Phase 1 (Dose Exploration): Change in FEV1, Phase 1 (Dose Exploration): Change in St. George’s Respiratory Questionnaire (SGRQ), Phase 1 (Dose Exploration): Change from baseline in blood levels of total AAT, Phase 2 (Dose Expansion): Rate of decline in whole-lung density (15th percentile lung density) at TLC as assessed by centrally read high-resolution CT, Phase 2 (Dose Expansion): Change in COPD exacerbations (defined in Appendix 2), Phase 2 (Dose Expansion): Change in FEV1, Phase 2 (Dose Expansion): Change in SGRQ, Phase 2 (Dose Expansion): Change from baseline in blood levels of total AAT, Phase 2 (Dose Expansion): Blood levels of Z-AAT and M-AAT, Phase 2 (Dose Expansion): Change in blood levels of functional AAT, Phase 2 (Dose Expansion): AUC0-last, AUC∞, Cmax, Tmax, t½ for the plasma levels of mRNA, gRNA, and lipids (ALC-0366 and ALC-0159), Phase 2 (Pivotal Cohort): Mean percent change from baseline in Z-AAT in blood through Month 12, Phase 2 (Pivotal Cohort): Proportion of patients with mean total AAT in blood ≥11 μM through Month 12, Phase 2 (Pivotal Cohort): Total AAT in blood over time, Phase 2 (Pivotal Cohort): Mean percent change from baseline in total AAT in blood through Month 12, Phase 2 (Pivotal Cohort): Mean percent change from baseline in functional AAT in blood through Month 12, Phase 2 (Pivotal Cohort): Mean M-AAT in blood through Month 12, Phase 2 (Pivotal Cohort): Mean Z-AAT in blood through Month 12, Phase 2 (Pivotal Cohort): Mean proportion of M-AAT in blood through Month 12, Phase 2 (Pivotal Cohort): Mean proportion of Z-AAT in blood through Month 12, Phase 2 (Pivotal Cohort): Functional AAT in blood over time, Phase 2 (Pivotal Cohort): M-AAT in blood over time, Phase 2 (Pivotal Cohort): Proportion of M-AAT in blood over time, Phase 2 (Pivotal Cohort): Z-AAT in blood over time, Phase 2 (Pivotal Cohort): Proportion of Z-AAT in blood over time, Phase 2 (Pivotal Cohort): Durability of treatment as measured by mean total AAT, mean functional AAT, mean M-AAT, and mean Z-AAT through Months 18, 24, and 36, Phase 2 (Pivotal Cohort): Maximum total AAT in blood with inflammatory response, Phase 2 (Pivotal Cohort): Rate of decline in whole-lung density (15th percentile lung density) at TLC as assessed by centrally read high-resolution CT, Phase 2 (Pivotal Cohort): Rate of severe COPD exacerbations (defined in Appendix 2), Phase 2 (Pivotal Cohort): Change in FEV1, Phase 2 (Pivotal Cohort): Change in SGRQ, Phase 2 (Pivotal Cohort): AUC0-last, AUC∞, Cmax, Tmax, t½ for the plasma levels of mRNA, gRNA, and lipids (ALC-0366 and ALC-0159), Phase 2 (Pivotal Cohort): Rates of TEAEs and SAEs

Source: https://euclinicaltrials.eu/ctis-public/view/2023-509256-34-00